EU clinical trial 2025-524192-24-00: A Phase I, Open-label, Multi-center, First-in-human Trial to Investigate E303, in Participants with Advanced Refractory Solid Tumors
Protocol code: E303-1001
Sponsor: Samsung Bioepis Co. Ltd. (Pharmaceutical company). Phase: Human Pharmacology (Phase I)- First administration to humans. Countries: Spain (ongoing, recruiting).
Therapeutic area(s): Diseases [C] - Neoplasms [C04]
Gender: Female, Male. Age: 18-64 years, 65+ years. Enrolment: 40.
Status: Ongoing, recruiting. Start date (EU): 2026-05-29. Decision date: 2026-05-18. Results received: No. Last updated: 2026-05-18.

Condition(s): advanced refractory solid tumors

Source: https://euclinicaltrials.eu/ctis-public/view/2025-524192-24-00